EU clinical trial 2024-513422-38-00: Phase III study of Isatuximab-Carfilzomib-Lenalidomide-Dexamethasone (Isa-KRd) versus Carfilzomib-Lenalidomide-Dexamethasone (KRd) in newly diagnosed multiple myeloma patients eligible for autologous stem cell transplantation (IsKia TRIAL)
Protocol code: EMN24
Sponsor: European Myeloma Network B.V., Emn Trial Office S.r.l. Impresa Sociale (Patient organisation/association, Laboratory/Research/Testing facility). Phase: Therapeutic confirmatory (Phase III). Countries: Germany (ongoing, recruitment ended), Belgium (ongoing, recruitment ended), Norway (ongoing, recruitment ended), Italy (ongoing, recruitment ended), Czechia (ongoing, recruitment ended), Netherlands (ongoing, recruitment ended), Spain (ongoing, recruitment ended), Greece (ongoing, recruitment ended).
Therapeutic area(s): Diseases [C] - Neoplasms [C04]
Gender: Female, Male. Age: 18-64 years, 65+ years. Enrolment: 302.
Status: Ongoing, recruitment ended. Start date (EU): 2020-09-28. Decision date: 2024-09-03. Results received: No. Last updated: 2026-05-27.
Decision dates by country: BE: 2024-09-03, DE: 2024-09-03, NL: 2024-09-03, IT: 2024-09-24, ES: 2024-09-09, NO: 2024-09-04, CZ: 2024-09-05, GR: 2024-10-11

Condition(s): Newly diagnosed multiple myeloma
Product: SOLDESAM 0,2% gocce orali, soluzione, Revlimid 20 mg hard capsules, Revlimid 25 mg hard capsules, ISATUXIMAB, Revlimid 15 mg hard capsules, ISATUXIMAB, Dexsol 2mg/5ml Oral Solution, Revlimid 10 mg hard capsules, Kyprolis 60 mg powder for solution for infusion, Revlimid 5 mg hard capsules

Primary endpoint: The rate of MRD negativity is determined as the proportion of patients with MRD negativity (≥10 -5 sensitivity level) after ASCT consolidation treatment using ITT principle. For patients who withdraw from the study or are lost to follow up before four post ASCT consolidation cycles, the best MRD assessment will be considered. Patients will be classified as MRD positive if they have only MRD positive test results or do not undergo MRD assessment.
Endpoint(s): The rate of MRD negativity after induction is determined as the proportion of patients with MRD negativity after the induction phase using ITT principle. Patients will be classified as MRD positive if they have only MRD positive test results or do not undergo MRD assessment/sample not adequate., PFS will be measured from the date of randomization to the date of first observation of PD, or death from any cause as an event. Subjects who have not progressed or who withdraw from the study will be censored at the time of the last complete disease assessment. All subjects who were lost to FU will also be censored at the time of last complete disease assessment., The rate of MRD negativity after light consolidation is determined as the proportion of patients with MRD negativity after light consolidation phase using ITT principle. Patients will be classified as MRD positive if they have only MRD positive test results or do not undergo MRD assessment/sample not adequate. Patients who withdraw from the study or are lost to follow up before MRD evaluation, the best MRD assessment will be considered., Rate of 1 year sustained MRD negativity by NGS will be also evaluated., Response rate will be evaluated according to IMWG Response criteria after induction, ASCT, post ASCT consolidation and light consolidation., The description of this secondary endpoint exceeds the number of allowed characters in this field. Please refer to the protocol enclosed in this application, TTP will be measured from the date of randomization to the date of first observation of PD, or deaths for PD. Subjects who have not progressed or who withdraw from the study or die from causes other than PD will be censored at the time of the last complete disease assessment. Subjects lost to FU will also be censored at the time of last complete disease assessment., DOR is defined as time between first documentation of response and PD with deaths owning to causes other than progression not counted, but censored. Responders without disease progression at the cut-off date of final analysis will be censored either at the time of lost to FU, at the time of death due to other cause than PD, or at the at the time of last contact., OS is defined as the time between randomization and death, regardless cause of death. Subjects who withdraw consent will be censored at the time of withdrawal. Subjects who are still alive at the cut-off date of final analysis will be censored at the cut-off date. Subjects lost to FU will also be censored at the time of last contact., TNT will be measured from the date of randomization to the date of next anti-myeloma therapy. Death due to any cause before starting therapy will be considered an event. Subjects who have not progressed or who withdraw from the study will be censored at the time of the last complete disease assessment. Subjects lost to FU will also be censored at the time of last contact., Determine safety in the 2 treatment arms in the different phases., Determine whether tumor response and outcome may change in subgroups with different prognosis according to current prognostic factors., The rate of MRD negativity after ASCT is determined as the proportion of patients with MRD negativity , NGS using ITT principle. For patients who withdraw from the study or are lost to follow up before ASCT, the best MRD assessment will be considered. Patients will be classified as MRD positive if they have only MRD positive test results or do not undergo MRD assessment., The rate of MRD negativity after induction, ASCT, post ASCT consolidation and light consolidation are determined as the proportion of patients with MRD negativity after the specific phase using ITT principle. Patients will be classified as MRD positive if they have only MRD positive test results or do not undergo MRD assessment. Patients who withdraw from the study or are lost to follow up before MRD evaluation phase, the best MRD assessment will be considered., The duration of MRD Negativity is defined as time between first MRD Negativity and first MRD positivity. Patients without MRD positivity will be censored at last complete assessment., Determine the rate of sustained for 1-year MRD negativity., Determine the success of stem cell harvest according to baseline characteristics; stem cells will be harvested at a minimum of 4 x 10^6 CD34+ cells/kg., Determine the success of engraftment after ASCT, defined by the time needed to achieve: Absolute Neutrophil Count (ANC) and Platelet count, Quality of life defined by EORTC QLQ-C30, EORTC QLQ-MY20 and EQ5D5L.

Source: https://euclinicaltrials.eu/ctis-public/view/2024-513422-38-00